EU clinical trial 2024-515299-11-00: PRODIGE 33 - BALLAD - Phase III study to evaluate the benefit of adjuvant chemotherapy in small bowel adenocarcinoma.
Protocol code: PRODIGE 33 -BALLAD
Sponsor: Centre Hospitalier Universitaire De Dijon (Hospital/Clinic/Other health care facility). Phase: Therapeutic confirmatory (Phase III). Countries: France (ongoing, recruitment ended).
Therapeutic area(s): Diseases [C] - Neoplasms [C04]
Gender: Female, Male. Age: 18-64 years, 65+ years. Enrolment: 100.
Status: Ongoing, recruitment ended. Start date (EU): 2024-10-18. Decision date: 2024-10-18. Results received: No. Last updated: 2024-10-18.

Condition(s): SMALL BOWEL ADENOCARCINOMA
Product: FOLINIC ACID, CAPECITABINE, FLUOROURACIL, FLUOROURACIL, OXALIPLATIN

Primary endpoint: Disease-free survival (DFS) is the primary endpoint of the study. It is defined as the time from randomisation to the first occurrence of the following events: - Recurrence of disease (confirmed by imaging) - Development of a new primary tumour (confirmed by imaging and histology/cytology) - Death Patients who do not present any of these events will be censored at the date of last news.
Endpoint(s): Overall survival: the survival status of patients will be determined at each follow-up visit., Chemotherapy toxicity: toxicity will be assessed using the CTCAE version 4.0 classification. Only toxicities of at least grade 2 will be recorded in the CRF., Quality of life: this will be assessed using the EORTC QLQ-C30, EORTC QLQ-CR29 and EQ-5D questionnaires., Health economics: to assess the cost-effectiveness of 24 weeks of adjuvant chemotherapy compared with observation alone, and of 24 weeks of adjuvant 5-FU/capecitabine monotherapy compared with 5-FU/capecitabine plus oxaliplatin. The results will be reported in terms of incremental cost per DFS and incremental cost per QALY.

Source: https://euclinicaltrials.eu/ctis-public/view/2024-515299-11-00